EU clinical trial 2024-517718-13-01: Detection of tumor tiSsue in pEritoneal metastases of coLorectal origin using a VEGF-targeted optical fluoresCent imaging tracer during diagnosTic laparoscopy
Protocol code: Panama ID: 8070
Sponsor: Universitair Medisch Centrum Groningen (Hospital/Clinic/Other health care facility). Phase: Human Pharmacology (Phase I)- Other. Countries: Netherlands (ongoing, recruiting).
Therapeutic area(s): Diseases [C] - Neoplasms [C04]
Gender: Female, Male. Age: 18-64 years, 65+ years. Enrolment: 13.
Status: Ongoing, recruiting. Start date (EU): 2024-11-25. Decision date: 2024-10-29. Results received: No. Last updated: 2024-10-29.

Condition(s): peritoneal metastases of colorectal origin

Source: https://euclinicaltrials.eu/ctis-public/view/2024-517718-13-01